EU clinical trial 2024-511577-29-01: Short course radiotherapy versus chemoradiotherapy, followed by consolidation chemotherapy, and selective organ preservation for MRI-defined intermediate and high-risk rectal cancer patients, A randomized phase III trial of the German Rectal Cancer Study Group
Protocol code: ACO/ARO/AIO-18.1
Sponsor: Goethe University Frankfurt (Educational Institution). Phase: Therapeutic confirmatory (Phase III). Countries: Germany (ongoing, recruitment ended).
Therapeutic area(s): Diseases [C] - Neoplasms [C04]
Gender: Female, Male. Age: 18-64 years, 65+ years. Enrolment: 688.
Status: Ongoing, recruitment ended. Start date (EU): 2020-03-13. Decision date: 2024-09-26. Results received: No. Last updated: 2026-07-06.

Condition(s): intermediate and high-risk rectal cancer
Product: Oxaliplatin Accord 5 mg/ml, Konzentrat zur Herstellung einer Infusionslösung, Xeloda 150 mg film-coated tablets, Xeloda 500 mg film-coated tablets, 5-FU medac 50 mg/ml, Injektionslösung, Calciumfolinat-GRY® 100 mg/10 ml Injektionslösung, Calciumfolinat-GRY® 300 mg/30 ml Injektionslösung, Calciumfolinat-GRY® 500 mg/50 ml Injektionslösung

Primary endpoint: The primary endpoint of this trial, organ preservation, is defined as follows: survival with rectum intact, no major surgery, no stoma.
Endpoint(s): Disease-free survival, Rate of clinical complete response after TNT, Rate of immediate TME after TNT, Cumulative incidence of locoregional regrowth after cCR, Rate of salvage surgery (LE/TME with or without APR/stoma) after locoregional regrowth, Cumulative incidence of local recurrence after (salvage) surgery, Postoperative complications of (salvage) surgery, Rate of sphincter-sparing (salvage) surgery, Pathological TNM-staging, R0 resection rate; negative circumferential resection rate, Tumor regression grading according to Dworak, Neoadjuvant rectal score, Quality of TME according to MERCURY, Acute and late toxicity assessment according to NCI CTCAE V.5.0), Quality of life and functional outcome based on treatment arm and surgical procedures/organ preservation, Cumulative incidence of distant metastases, Overall survival, Translational / biomarker studies

Source: https://euclinicaltrials.eu/ctis-public/view/2024-511577-29-01